EU clinical trial 2023-504328-25-00: A parallel-group treatment, Phase 2, double-blind, placebo controlled study to evaluate the efficacy and safety of SAR444656 in adult participants with moderate to severe hidradenitis suppurativa.
Protocol code: ACT17841
Sponsor: Sanofi-Aventis Recherche & Developpement (Pharmaceutical company). Phase: Therapeutic exploratory (Phase II). Countries: Spain (ended), Greece (ended), Germany (ended), Poland (ended).
Therapeutic area(s): Diseases [C] - Skin and Connective Tissue Diseases [C17]
Gender: Female, Male. Age: 18-64 years, 65+ years. Enrolment: 208.
Status: Ended. Start date (EU): 2023-12-27. End date (EU): 2025-06-23. End date: 2025-11-12. Decision date: 2023-11-28. Results received: No. Last updated: 2025-07-03.
Decision dates by country: GR: 2023-12-04, PL: 2023-11-30, ES: 2023-11-28, DE: 2023-11-28

Condition(s): hidradenitis suppurativa
Product: SAR444656, Matched Placebo

Primary endpoint: Percent change from baseline in total abscess and inflammatory nodule (AN) count
Endpoint(s): Proportion of participants achieving Hidradenitis Suppurativa Clinical Response 50 (HiSCR 50), Proportion of participants achieving AN count ≤2, Absolute change from baseline in International Hidradenitis Suppurativa Severity Score System (IHS4), Proportion of participants with improvement from baseline in Hurley Stage, Proportion of participants achieving AN50 (at least 50% reduction in the AN count relative to baseline), Change from baseline in participants reported daily worst pain using HS-Skin Pain-Numerical Rating Scale (HS-Skin Pain-NRS), Proportion of participants achieving improvement defined as at least 30% redaction and at least 1 unit reduction in participant daily worst pain using HS-Skin pain-NRS, Change from baseline in the amount of analgesic, Incidence of treatment-emergent adverse events (TEAEs), serious adverse events (SAEs), and adverse events of special interest (AESIs), investigational medicinal product (IMP) discontinuation due to TEAEs, Plasma SAR444656 concentration

Source: https://euclinicaltrials.eu/ctis-public/view/2023-504328-25-00